EU clinical trial 2023-505834-84-00: e-REVRI - A Phase 2 Study evaluating Epcoritamab in subjects with relapsed and refractory primary diffuse large B-cell lymphoma of the CNS treated with Lenalidomide and Rituximab
Protocol code: e-REVRI
Sponsor: Lysarc (Pharmaceutical company). Phase: Phase II and Phase III (Integrated). Countries: France (ongoing, recruiting).
Therapeutic area(s): Diseases [C] - Hemic and Lymphatic Diseases [C15]
Gender: Female, Male. Age: 18-64 years, 65+ years. Enrolment: 60.
Status: Ongoing, recruiting. Start date (EU): 2025-06-17. Decision date: 2025-02-27. Results received: No. Last updated: 2025-10-22.

Condition(s): relapsed and refractory primary diffuse large B-cell lymphoma of the CNS
Product: RITUXIMAB, LENALIDOMIDE, EPCORITAMAB, RITUXIMAB, EPCORITAMAB

Primary endpoint: The primary endpoint is the best Objective Response rate (ORR) during the first 8 cycles corresponding to the induction phase (or at permanent treatment discontinuation) as determined by central review according to the International group for primary CNS lymphoma (IPCG) recommendations in the R/R PCNSL cohort.
Endpoint(s): Objective response rate (CR + CRu + PR) after 8 cycles of study treatment or at permanent treatment discontinuation according to IPCG recommendations as determined by investigator assessment, Best objective response rate (CR + CRu + PR) during the first 8 cycles corresponding to the induction phase (or at permanent treatment discontinuation) in the PVRL cohort according to the IPCG recommendations by investigator assessment, Objective response rate (CR + CRu + PR) after 8 cycles of study treatment or at permanent treatment discontinuation in the PVRL cohort according to the IPCG recommendations by investigator assessment, Best complete response rate (CR+CRu) during the first 8 cycles corresponding to the induction phase (or at permanent treatment discontinuation) according to the IPCG recommendations as determined by investigator assessment, Time to objective response (TTR) according to IPCG recommendations, Progression-free survival (PFS) according to IPCG recommendations, Duration of response (DOR) according to IPCG recommendations, Overall Survival (OS), Time to next treatment (TTNT)

Source: https://euclinicaltrials.eu/ctis-public/view/2023-505834-84-00